EU clinical trial 2024-517055-13-00: Does high-dose vitamin B3 supplementation prevent major adverse kidney events during septic shock? A multicenter randomized controlled study.
Protocol code: PI2020_843_0027
Sponsor: Centre Hospitalier Universitaire Amiens Picardie (Hospital/Clinic/Other health care facility). Phase: Therapeutic confirmatory (Phase III). Countries: France (ended).
Therapeutic area(s): Not possible to specify
Gender: Female, Male. Age: 18-64 years, 65+ years. Enrolment: 310.
Status: Ended. End date (EU): 2025-09-11. Decision date: 2024-09-13. Results received: No. Last updated: 2025-06-02.

Condition(s): adverse kidney events during septic shock
Product: VITAMINE PP AGUETTANT 500 mg/5 ml, solution injectable, CHLORURE DE SODIUM 0,9 % AGUETTANT, solution pour perfusion, CHLORURE DE SODIUM FRESENIUS 0,9 %, solution injectable

Primary endpoint: the proportion of patients meeting one or more criteria for MAKE30: inhospital mortality, receipt of new RRT, or persistent renal dysfunction defined as a final inpatient serum creatinine value ≥2 time baseline serum creatinine on day 30
Endpoint(s): The reduction in the incidence of moderate to severe AKI defined as stage 2 and 3 of the KDIGO 2012 classification., The increase in the number of days living without renal replacement therapy (censored at death or at day 30)., Length of hospital stay: defined as the time between admission date of admission and discharge for subjects discharged alive from the resuscitation, Reduction of the incidence of major renal adverse events at J90 (MAKE 90).The reduction of the intensive care unit length of stay., liver toxicity, checked on day 1, Day2, day 3 and day 7 (transaminases, bilirubin, alkaline phosphatase, gamma-glutamyltransferase), nausea, vomiting, headache, flushing, facial erythema, Evaluate the effectiveness of Nicotinamide supplementation according to the urinary quinolonate/ tryptophan ratio on D0 and D1

Source: https://euclinicaltrials.eu/ctis-public/view/2024-517055-13-00